EU clinical trial 2024-519561-22-00: A Randomized, Double-Blind, Placebo-Controlled Phase 2 Trial to Assess Efficacy, Safety, and Tolerability of RO7204239 in Combination with Tirzepatide in Participants with Obesity or Overweight with at least One Weight-Related Comorbidity
Protocol code: BC45538
Sponsor: F. Hoffmann-La Roche AG (Pharmaceutical company). Phase: Therapeutic exploratory (Phase II). Countries: Poland (ongoing, recruitment ended), Spain (ongoing, recruitment ended).
Therapeutic area(s): Diseases [C] - Nutritional and Metabolic Diseases [C18]
Gender: Female, Male. Age: 18-64 years, 65+ years. Enrolment: 78.
Status: Ongoing, recruitment ended. Start date (EU): 2025-07-07. Decision date: 2025-06-09. Results received: No. Last updated: 2026-07-15.
Decision dates by country: ES: 2025-06-09, PL: 2025-06-23

Condition(s): Obesity
Product: Mounjaro 5 mg/dose KwikPen solution for injection in pre-filled pen, Mounjaro 2.5 mg/dose KwikPen solution for injection in pre-filled pen, Mounjaro 10 mg/dose KwikPen solution for injection in pre-filled pen, Mounjaro 15 mg/dose KwikPen solution for injection in pre-filled pen, Mounjaro 10 mg/dose KwikPen solution for injection in pre-filled pen, RO7204239, RO7204239 Placebo, Mounjaro 2.5 mg/dose KwikPen solution for injection in pre-filled pen, Mounjaro 15 mg/dose KwikPen solution for injection in pre-filled pen, Mounjaro 7.5 mg/dose KwikPen solution for injection in pre-filled pen, Mounjaro 12.5 mg/dose KwikPen solution for injection in pre-filled pen, Mounjaro 7.5 mg/dose KwikPen solution for injection in pre-filled pen, Mounjaro 12.5 mg/dose KwikPen solution for injection in pre-filled pen, Mounjaro 5 mg/dose KwikPen solution for injection in pre-filled pen

Primary endpoint: Percent (%) change in body weight from baseline at Week 48
Endpoint(s): Change from baseline at Week 48 •Absolute change in body weight (kg), Change from baseline at Week 48 •Change in body mass index (BMI) (kg/m2), Change from baseline at Week 48 •Waist-to-height ratio, Change from baseline at Week 48 •Waist circumference, Change from baseline at Week 48 in •Total body fat mass (kg and %) by dual-energy x-ray absorptiometry (DXA), Change from baseline at Week 48 in •Total lean body mass (kg and %) by DXA, Change from baseline at Week 48 in •Appendicular lean mass (kg and %) by DXA, Change from baseline at Week 48 in •Muscle volume (%) by magnetic resonance imaging (MRI), Change from baseline at Week 48 in •Muscle fat infiltration (%) by MRI, Change from baseline at Week 48 in the following markers •Glucose metabolism: glycated hemoglobin (HbA1c), fasting plasma glucose, fasting C-peptide, and fasting insulin; Homeostasis Model Assessment of Insulin Resistance (HOMA-IR); Quantitative Insulin Sensitivity Check Index (QUICKI), Change from baseline at Week 48 in the following markers •Fasting lipid profile: total cholesterol, triglycerides, low-density lipoprotein (LDL), high-density lipoprotein (HDL), non-HDL cholesterol, Incidence, severity, and causal relationship of AEs as reported by the Investigator, with severity determined according to National Cancer Institute Common Terminology Criteria for Adverse Events v5.0 (NCI CTCAE, v5.0), Change from baseline in vital signs, physical findings, ECG, and clinical laboratory results, Incidence of local and systemic injection reactions, Incidence of abnormal laboratory findings, Incidence of abnormal ECG parameters, Incidence of abnormal vital signs, Serum concentrations of RO7204239 at specified timepoints, PK parameters of RO7204239 including Ctrough,ss and t1/2 (if appropriate), Estimated PK parameters of RO7204239 using a population-PK model including AUCtau,ss, Cmax,ss, CL/F, and Vd/F, Prevalence of anti-drug antibodies (ADAs) at baseline and incidence of ADAs during the study

Source: https://euclinicaltrials.eu/ctis-public/view/2024-519561-22-00